EU clinical trial 2025-522801-39-00: IFCT-2501 IDEATION ctDNA-guIDEd consolidATION immunotherapy after chemoradiotherapy in patients with stage III non-small cell lung cancer
Sponsor: Intergroupe Francophone De Cancerologie Thoracique (Patient organisation/association). Phase: Therapeutic exploratory (Phase II). Countries: France (authorised, recruitment pending).
Therapeutic area(s): Diseases [C] - Neoplasms [C04]
Gender: Female, Male. Age: 18-64 years, 65+ years. Enrolment: 177.
Status: Authorised, recruitment pending. Decision date: 2026-07-02. Results received: No. Last updated: 2026-07-02.

Condition(s): Stage III Non Small Cell Lung Cancer
Product: IMFINZI 50 mg/mL concentrate for solution for infusion

Primary endpoint: 12-month PFS rate from randomization as assessed by an independent review committee.
Endpoint(s): Investigator-assessed PFS from randomization, OS from randomization., Incidence, nature, and severity of adverse events, graded according to the National Cancer Institute Common Terminology Criteria for Adverse Events, Version 6.0 (NCI CTCAE v6.0)., Global and specific quality of life questionnaires QLQ-C30 QLQ-LC29 and EQ-5D-5L.

Source: https://euclinicaltrials.eu/ctis-public/view/2025-522801-39-00